EU clinical trial 2023-507534-24-00: A Phase 1b/2a, Dose Escalation Trial of Safety, Pharmacokinetic/Pharmacodynamic and Preliminary Clinical Activity of Briquilimab in Adult Patients with Chronic Inducible Urticaria (CIndU) Who Remain Symptomatic Despite Treatment with H1-Antihistamines
Protocol code: JSP-CP-010
Sponsor: Jasper Therapeutics Inc. (Pharmaceutical company). Phase: Phase I and Phase II (Integrated)- Other. Countries: Germany (ended).
Therapeutic area(s): Diseases [C] - Skin and Connective Tissue Diseases [C17]; Diseases [C] - Immune System Diseases [C20]
Gender: Female, Male. Age: 18-64 years, 65+ years. Enrolment: 20.
Status: Ended. Start date (EU): 2024-03-06. End date (EU): 2025-07-31. End date: 2025-08-01. Decision date: 2023-12-22. Results received: No. Last updated: 2024-09-23.

Condition(s): Chronic Inducible Urticaria
Product: EPINEPHRINE, Briquilimab

Primary endpoint: Incidence and severity of treatment emergent AEs/SAEs, Laboratory assessments, ECG, vital signs, Supervision of expected AEs: Taste change assessments Hair color change assessment
Endpoint(s): Provocation testing: ColdU: Critical temperature threshold (CCT) SD: Critical friction threshold (CFT), Urticaria Control Test (UCT), Complete response rate: Proportion of participants who are urticaria free based on UCT = 16, Well-controlled rate: Proportion of participants who are well controlled based on UCT ≥ 12, Time to complete response or well-controlled disease, Time to relapse, Serum PK concentration of briquilimab over time - Modelled serum PK parameters of briquilimab including but not limited to Cmax, Cmin and AUC as appropriate

Source: https://euclinicaltrials.eu/ctis-public/view/2023-507534-24-00